EU clinical trial 2024-517805-10-01: Sodium-oxybate as a potential new treatment for catatonia in patients with depression, bipolar disorder or a psychotic disorder, a randomized controlled trial. the Laborit study
Protocol code: NL7793801823
Sponsor: Amsterdam UMC Stichting (Patient organisation/association). Phase: Therapeutic confirmatory (Phase III). Countries: Netherlands (authorised, recruiting).
Therapeutic area(s): Psychiatry and Psychology [F] - Mental Disorders [F03]
Gender: Female, Male. Age: 18-64 years, 65+ years. Enrolment: 42.
Status: Authorised, recruiting. Start date (EU): 2024-11-12. Decision date: 2024-11-12. Results received: No. Last updated: 2024-11-12.

Condition(s): Catatonia
Product: SODIUM OXYBATE

Primary endpoint: The response rate after four days of treatment in both groups (lorazepam and sodium oxybate) as measured by difference in BFCRS scores. Response is defined as a 50% reduction in symptoms based on the BFCRS

Source: https://euclinicaltrials.eu/ctis-public/view/2024-517805-10-01